EU clinical trial 2023-506028-10-00: A Phase 1/2, Randomized, Double-blind, Placebo‑controlled Single- and Multiple‑dose Escalation Study Evaluating the Safety, Tolerability, Pharmacokinetics, and Pharmacodynamics of VX‑670 in Adult Subjects with Myotonic Dystrophy Type 1
Protocol code: VX23-670-001
Sponsor: Vertex Pharmaceuticals Inc. (Pharmaceutical company). Phase: Phase I and Phase II (Integrated)- First administration to humans. Countries: Netherlands (ongoing, recruiting), Spain (ongoing, recruiting), Belgium (ongoing, recruiting), France (authorised, recruiting), Germany (ongoing, recruiting), Italy (authorised, recruiting).
Therapeutic area(s): Diseases [C] - Musculoskeletal Diseases [C05]
Gender: Female, Male. Age: 18-64 years. Enrolment: 20.
Start date (EU): 2024-12-11. Decision date: 2024-03-18. Results received: No. Last updated: 2026-08-04.
Decision dates by country: NL: 2024-03-22, BE: 2024-04-16, ES: 2024-04-16, FR: 2024-04-16, IT: 2024-04-16, DE: 2024-04-16

Condition(s): Myotonic Dystrophy
Product: 0.9% saline solution (w/v), VX-670 Solution for Injection/Infusion

Primary endpoint: Parts A and B: Safety and tolerability of VX-670 based on the assessment of adverse events (AEs), laboratory test results, standard 12-lead electrocardiograms (ECGs), vital signs, Columbia Suicide Severity Rating Scale (C-SSRS)
Endpoint(s): Parts A: PK parameter estimates of VX-670 derived from plasma concentration time data, Part B: - PK parameter estimates of VX-670 and PMO-0221a derived from plasma concentration time data - PK parameter estimates of VX-670 and PMO-0221a derived from muscle concentration data - Change from baseline in splicing index in the muscle biopsy

Source: https://euclinicaltrials.eu/ctis-public/view/2023-506028-10-00